EU clinical trial 2023-507452-77-00: Impact of CardiolRxTM on Recurrent Pericarditis: An open label Pilot Study
Protocol code: Cardiol 100-004
Sponsor: Cardiol Therapeutics Inc. (Pharmaceutical company). Phase: Human Pharmacology (Phase I)- Other. Countries: France (ended).
Therapeutic area(s): Diseases [C] - Cardiovascular Diseases [C14]
Gender: Female, Male. Age: 18-64 years, 65+ years. Enrolment: 10.
Status: Ended. End date (EU): 2024-02-20. End date: 2024-09-06. Decision date: 2024-01-05. Results received: No. Last updated: 2024-01-05.

Condition(s): Recurrent Pericarditis

Source: https://euclinicaltrials.eu/ctis-public/view/2023-507452-77-00